EU clinical trial 2024-511906-21-00: Efficacy of Tocilizumab in association to steroids in giant cell arteritis with cerebro-vascular involvement patients (ToGiAS). A french prospective multicentre randomized versus placebo phase III trial (TOGIAC)
Protocol code: APHP191062
Sponsor: Assistance Publique Hopitaux De Paris (Hospital/Clinic/Other health care facility). Phase: Therapeutic confirmatory (Phase III). Countries: France (ended).
Therapeutic area(s): Diseases [C] - Cardiovascular Diseases [C14]; Diseases [C] - Nervous System Diseases [C10]
Gender: Female, Male. Age: 18-64 years, 65+ years. Enrolment: 60.
Status: Ended. Start date (EU): 2021-09-24. End date (EU): 2025-08-01. Decision date: 2024-11-19. Results received: No. Last updated: 2025-02-26.

Condition(s): Giant cell arteritis with Cerebro-vascular involvement
Product: TOCILIZUMAB, Placebo of Tocilizumab

Primary endpoint: The primary endpoint is composite: complete remission of GCA with cerebrovascular involvement (clinical, biological, and PET uptake) including absence of clinical and MRI ischemic stroke recurrence at 24 weeks
Endpoint(s): Relapse-free survival will be assessed at weeks 4, 12, 24 and 52, Time to remission will be assessed at weeks 4, 12, 24 and 52, Serious adverse event-free survival will be assessed at weeks 4, 12, 24 and 52, Neurovascular imaging improvement: angio-CT improvement of vasculitis lesions and /or improvement or disappearance of PET FDG uptake will be assessed at weeks 4, 12, 24 and 52, Number and percentages of deaths Relapse-free survival will be assessed at weeks 4, 12, 24 and 52, Number and percentages of patients with rankin score 0-1 Relapse-free survival will be assessed at weeks 4, 12, 24 and 52, Percentage of clinical and MRI ischemic stroke recurrence at 24 weeks, Influence of tocilizumab treatment on cumulative steroid dose at 24 weeks, Safety of tocilizumab assessed by adverse events (mostly nasopharyngitis, headache, hypertension, injection site reactions and serious adverse events (mostly upper respiratory tract infections, but also rare liver damage), neutropenia and hypercholesterolemia

Source: https://euclinicaltrials.eu/ctis-public/view/2024-511906-21-00